EU clinical trial 2023-505363-37-00: A Phase 1/2a Double-Blind, Placebo-controlled, Single- and Multiple-Ascending Dose Study to Assess the Safety, Tolerability, Pharmacokinetics, Pharmacodynamics and Preliminary Clinical Efficacy of Intravenous Administration of ATX-01 In Male and Female Participants aged 18 to 64 with Classic Myotonic Dystrophy Type 1 (DM1)
Protocol code: CT-ATX-01-DM1-1.1
Sponsor: Arthex Biotech S.L. (Pharmaceutical company). Phase: Human Pharmacology (Phase I)- First administration to humans. Countries: Italy (ongoing, recruiting), France (ongoing, recruiting), Spain (ongoing, recruiting), Netherlands (ongoing, recruiting).
Therapeutic area(s): Diseases [C] - Nervous System Diseases [C10]
Gender: Female, Male. Age: 18-64 years. Enrolment: 28.
Status: Ongoing, recruiting. Start date (EU): 2024-08-12. Decision date: 2024-07-01. Results received: No. Last updated: 2026-08-07.
Decision dates by country: NL: 2025-05-30, FR: 2024-07-08, ES: 2024-07-01, IT: 2024-07-03

Condition(s): Myotonic dystrophy type 1 (DM1)
Product: Placebo, ATX-01

Primary endpoint: Incidence of Serious Adverse Events (SAEs), Incidence of Adverse Events of Special Interest (AESIs), Incidence of AEs leading to discontinuation of treatment, Incidence of Treatment Emergent Adverse Events (TEAEs)
Endpoint(s): Absolute values and changes from baseline in clinical safety laboratory tests and electrocardiogram (ECG) parameters, Absolute values and changes from baseline in urine kidney biomarkers (individual and Kidney Safety Composite Measure [KSCM]), Absolute values and changes from baseline in vital signs, Suicidal ideation and behavior assessed by the Columbia-Suicide Severity Rating Scale (C-SSRS), PK parameters of ATX-01 in plasma (including, but not limited to, area under the curve [AUC], maximum observed plasma concentration [Cmax], time from first dose at which Cmax was apparent [Tmax], apparent elimination half-life [t1/2]), PK parameters of ATX-01 in urine (including but not limited to amount excreted, CLR, excretion rate), PD biomarkers in the tibialis anterior: • Change from baseline in MBNL1 expression (target engagement) • Change from baseline in the RNA Splice Index, Change from baseline in video hand opening time (vHOT), Change from baseline in ankle dorsiflexion strength by quantitative myometry, Change from baseline in impact on ADL of myotonia, mobility, upper extremity function, breathing, stamina, GI symptoms (Impact on ADL questionnaire)

Source: https://euclinicaltrials.eu/ctis-public/view/2023-505363-37-00